EU clinical trial 2024-516382-37-00: Optimal Antiplatelet Treatment to Achieve Stroke Avoidance and Fall in Bleeding Events following Left Atrial Appendage Closure (SAFE-LAAC). Comparative Health Effectiveness Randomized Trial – PILOT Study
Protocol code: 2.52/IV/16
Sponsor: Narodowy Instytut Kardiologii Stefana Kardynala Wyszynskiego Panstwowy Instytut Badawczy (Hospital/Clinic/Other health care facility). Phase: Therapeutic use (Phase IV). Countries: Poland (authorised, recruitment pending).
Therapeutic area(s): Diseases [C] - Cardiovascular Diseases [C14]
Gender: Female, Male. Age: 18-64 years, 65+ years. Enrolment: 200.
Status: Authorised, recruitment pending. Decision date: 2024-12-16. Results received: No. Last updated: 2025-04-25.

Condition(s): Atrial fibrillation
Product: ACETYLSALICYLIC ACID, CLOPIDOGREL

Primary endpoint: comprising major adverse cardiac and cerebrovascular events defined as: 1. efficacy: MACCE - stroke, TIA, peripheral embolism, nonfatal myocardial infarction, cardiovascular and overall mortality; device related thrombosis; and 2. safety: moderate and severe bleedings (type 2-5 BARC).

Source: https://euclinicaltrials.eu/ctis-public/view/2024-516382-37-00